EU clinical trial 2024-520259-26-00: A Phase 3, Open-label Extension Study to Assess the Long-term Safety of KarXT for the Treatment of Mania or Mania with Mixed Features in Bipolar-I Disorder (BALSAM-3)
Protocol code: CN012-0038
Sponsor: Bristol-Myers Squibb Services Unlimited Company (Pharmaceutical company). Phase: Therapeutic confirmatory (Phase III). Countries: Hungary (authorised, recruiting), Romania (ongoing, recruiting), Poland (authorised, recruiting), Sweden (authorised, recruiting), Croatia (authorised, recruiting), Spain (authorised, recruiting), Slovakia (authorised, recruitment pending), Bulgaria (ongoing, recruiting), Italy (authorised, recruitment pending), France (authorised, recruitment pending), Denmark (authorised, recruitment pending).
Therapeutic area(s): Psychiatry and Psychology [F] - Mental Disorders [F03]
Gender: Female, Male. Age: 18-64 years, 65+ years. Enrolment: 174.
Start date (EU): 2025-09-25. Decision date: 2025-08-26. Results received: No. Last updated: 2026-06-16.
Decision dates by country: SE: 2025-08-27, HU: 2025-08-26, HR: 2025-08-29, BG: 2025-09-01, RO: 2025-09-08, ES: 2025-08-27, SK: 2025-08-26, IT: 2026-05-14, FR: 2026-06-16, PL: 2025-08-29, DK: 2026-06-16

Condition(s): Mania or Mania with Mixed Features in Bipolar-I Disorder
Product: KarXT, KarXT, KarXT, KarXT

Primary endpoint: To track any side effects that participants experience while receiving the treatment.
Endpoint(s): To monitor for: serious side effects, specific side effects of concern, side effects that cause participants to stop treatment., To observe any changes in how participants respond to questions about suicidal thoughts or behaviors., To measure changes from the beginning of the study in: Movement and coordination (using tests like BARS, SAS, and AIMS); Urinary symptoms (for male participants aged 45 and older, using the IPSS questionnaire).

Source: https://euclinicaltrials.eu/ctis-public/view/2024-520259-26-00